EU clinical trial 2023-508259-38-00: An open-label, prospective Phase III clinical study to compare polatuzumab vedotin plus rituximab, ifosfamide, carboplatin and etoposide (Pola-R-ICE) with rituximab, ifosfamide, carboplatin and etoposide (R-ICE) alone as salvage therapy in patients with primary refractory or relapsed diffuse large B-cell lymphoma (DLBCL)
Protocol code: MO40599/GLA 2017-R2
Sponsor: GWT-Tud GmbH (Pharmaceutical company). Phase: Therapeutic confirmatory (Phase III). Countries: Spain (ended), Austria (ended), Germany (ended).
Therapeutic area(s): Diseases [C] - Hemic and Lymphatic Diseases [C15]
Gender: Female, Male. Age: 18-64 years, 65+ years. Enrolment: 302.
Status: Ended. Start date (EU): 2021-04-29. End date (EU): 2025-12-19. Decision date: 2024-02-07. Results received: No. Last updated: 2025-11-05.
Decision dates by country: DE: 2024-05-06, AT: 2024-02-15, ES: 2024-02-07

Condition(s): Adult patients with relapsed or primary refractory DLBCL
Product: ETOPOPHOS® 100 mg, Pulver zur Herstellung einer Infusionslösung, MabThera 500 mg concentrate for solution for infusion, Carboplatino Pharmacia 10 mg/ml concentrado para solución para perfusión EFG, Holoxan, Etoposid Accord 20 mg/ml Konzentrat zur Herstellung einer Infusionslösung, Carboplatin onkovis 10 mg/ml Infusionslösung, Holoxan 2 g - Trockensubstanz zur Injektionsbereitung, Ifosfamide Injection 1g, Etopósido Sandoz 20 mg/ml concentrado para solución para perfusión EFG, Polivy 140 mg powder for concentrate for solution for infusion., Carboplatin Accord 10 mg/ml Konzentrat zur Herstellung einer Infusionslösung, Etoposid Accord 20 mg/ml Konzentrat zur Herstellung einer Infusionslösung, Holoxan 1 g -Trockensubstanz zur Injektionsbereitung

Primary endpoint: The primary endpoint is EFS of patients with DLBCL at first progression or relapse.
Endpoint(s): Secondary endpoints for efficacy are rate of metabolic CR after end of study treatment, PR rate, ORR, duration of response, progression rate, relapse rate, PFS, OS, number of CD34+ cells, mobilization failure rate, rate of patients proceeding to transplantation, and non-relapse mortality, Secondary safety endpoints: Adverse events (AE), Serious adverse events (SAE), Incidence and duration of neutropenia and thrombocytopenia Grade 4 CTC, Rate of treatment-related deaths, Second malignancies, Secondary endpoints for protocol adherence: Number of chemotherapy cycles, Duration of chemotherapy cycles, Cumulative dose and relative dose of ifosfamide, carboplatin and etoposide, Cumulative dose and relative dose of rituximab, Cumulative dose and relative dose of the polatuzumab vedotin, Secondary endpoints for QoL: Secondary endpoint is evaluation of generic health-related QoL as assessed by different questionnaires

Source: https://euclinicaltrials.eu/ctis-public/view/2023-508259-38-00